EU clinical trial 2023-503228-17-00: Combining intratumoral flu vaccine and systemic pembrolizumab in patients with early pMMR colorectal cancer – the FLU-IMMUNE trial.
Sponsor: Zealand University Hospital (Hospital/Clinic/Other health care facility). Phase: Therapeutic exploratory (Phase II). Countries: Denmark (ongoing, recruiting).
Therapeutic area(s): Diseases [C] - Neoplasms [C04]
Gender: Female, Male. Age: 18-64 years, 65+ years. Enrolment: 21.
Status: Ongoing, recruiting. Start date (EU): 2023-11-06. Decision date: 2023-04-21. Results received: No. Last updated: 2024-10-10.

Condition(s): Colorectal Cancer
Product: Influvactetra, injektionsvæske, suspension i fyldt injektionssprøjte, KEYTRUDA 25 mg/mL concentrate for solution for infusion, Influvac Tetra Saison 2024/2025 Injektionssuspension in einer Fertigspritze Influenza-Impfstoff aus Oberflächenantigen (inaktiviert)

Primary endpoint: The primary endpoint will be that 50% or more patients achieve a major pathological response (MPR) that will be defined as < 10 % viable cells corresponding to Mandard tumor regression grade 1-2 (MTRG).
Endpoint(s): Specific safety outcomes including tumor site perforation and delay of surgery, and changes in the recovery as assessed by the QoR-15 questionnaire, Analysis of tumor samples: Immunohistochemical analysis of CD3+ and CD8+ T cells, spatial protein expression analyses of immune-infiltrated regions of tumors at the different time points, flow cytometry, and full transcriptomic analyses including single cell analysis., Analysis of blood samples: flow cytometry and full transcriptomic analyses including single cell analysis.

Source: https://euclinicaltrials.eu/ctis-public/view/2023-503228-17-00